EU clinical trial 2024-511962-34-00: [18F]-olaparib PET; Molecular imaging of DNA damage response by [18F]-olaparib PET
Protocol code: 19310
Sponsor: Universitair Medisch Centrum Groningen (Hospital/Clinic/Other health care facility). Phase: Phase I and Phase II (Integrated)- First administration to humans. Countries: Netherlands (authorised, recruitment pending).
Therapeutic area(s): Diseases [C] - Neoplasms [C04]
Gender: Female, Male. Age: 18-64 years, 65+ years. Enrolment: 10.
Status: Authorised, recruitment pending. Decision date: 2025-04-22. Results received: No. Last updated: 2025-04-22.

Condition(s): Head and neck squamous cell carcinoma (HNSCC)

Primary endpoint: • Dose-activity curves for healthy organs, • Tumour: background ratio at different timepoints post-injection, • AEs until 30 days post-injection, • Correlation between standardised uptake value of [18F]-olaparib in tumour lesions, and PARP1 expression levels determined by immunohistochemistry
Endpoint(s): • Absolute and percentage increase in tumour [18F]-olaparib standardised uptake value after one week of chemoradiation compared to baseline tumour [18F]-olaparib standardised uptake value., • Correlation between standardised uptake value of [18F]-olaparib in tumour lesions, and PARP1 expression levels determined by immunohistochemistry after one week of chemoradiation.

Source: https://euclinicaltrials.eu/ctis-public/view/2024-511962-34-00